EU clinical trial 2022-501072-25-02: The safety and efficacy of acute subcutaneous administration of semaglutide in non-diabetic patients with acute ischemic stroke: a multicentre, phase 2, prospective, randomized, open-label, blinded endpoint trial (ASSET)
Sponsor: Aarhus University Hospital (Hospital/Clinic/Other health care facility). Phase: Therapeutic exploratory (Phase II). Countries: Denmark (ongoing, recruiting).
Therapeutic area(s): Diseases [C] - Cardiovascular Diseases [C14]; Diseases [C] - Nervous System Diseases [C10]
Gender: Female, Male. Age: 18-64 years, 65+ years. Enrolment: 380.
Status: Ongoing, recruiting. Start date (EU): 2023-04-12. Decision date: 2022-10-27. Results received: No. Last updated: 2023-06-20.

Condition(s): Ischemic Stroke
Product: Imodium, Hjertemagnyl, filmovertrukne tabletter 75 mg, Ozempic 0.5 mg solution for injection in pre-filled pen, Ozempic 0.25 mg solution for injection in pre-filled pen, Ondansetron Fresenius Kabi 2 mg/ml solution injectable, Actilyse, pulver og solvens til injektions-/infusionsvæske, opløsning

Primary endpoint: A shift toward better functional outcomes in the distribution of the modified Ranking Scale (mRS) (ordinal logistic regression)
Endpoint(s): Proportion of patients with a Serious Adverse Events and/or Serious Unexpected Serious Adverse Events within 90 days of randomization, 90-day mortality, One-year mortality, Frequency of predefined serious adverse events, Excellent functional outcome (modified Rankin Scale 0-1) at 90 days, Major Adverse Cardiac and Cerebral Events (MACCE) and recurrent ischemic events based on registry data at 3 months in AIS patients, Major Adverse Cardiac and Cerebral Events (MACCE) and recurrent ischemic events based on registry data at 12 months in AIS patients, Stroke recurrence at 12 months in patients with a stroke due to small vessel disease, Early neurological improvement (NIHSS_24hour – NIHSS_baseline), Change in body weight (kg) (week 12-baseline), Change in fasting plasma glucose (week 12-baseline), Change in body mass index (BMI) (week 12-baseline), Change in waist circumference (week 12-baseline), Difference in HbA1c (week 12-baseline), Diabetes diagnosis and/or antidiabetic medication (week 52), Systolic and diastolic blood pressure (week 12 BP - discharge BP), Change in Quality of life (EQ5D, week 12- baseline), Change in Major Depression Inventory (MDI, week 12- baseline), Difference in activities of daily living - Multi Data Set –Home Care (MDS-HC, week 12), 24-hour infarct growth on DWI-MRI, Acute and long-term platelet inhibition in Semaglutide treated patients, The effect of semaglutide in non-diabetic stroke patients on insulin, c-peptide, glucagon and 3-hydroxybuturate levels, The effect of semaglutide in non-diabetic stroke patients on leptin, cholecystokinin (CCK) and gastric inhibitory polypeptide (GIP), Proportion of patients diagnosed with dementia (all-cause) at 12 months, Change in TICS score (12 months - 90 days)

Source: https://euclinicaltrials.eu/ctis-public/view/2022-501072-25-02